EU clinical trial 2022-502369-10-00: ISIdE: Open label, multicentric, single-arm phase IIIB trial to evaluate the safety and efficacy of sacituzumab govitecan in triple negative metastatic breast cancer patients with a biomarker analysis.
Protocol code: UC-BCG-2204
Sponsor: Unicancer (Hospital/Clinic/Other health care facility). Phase: Therapeutic confirmatory (Phase III). Countries: France (ongoing, recruitment ended), Belgium (ongoing, recruitment ended).
Therapeutic area(s): Diseases [C] - Neoplasms [C04]
Gender: Female, Male. Age: 18-64 years, 65+ years. Enrolment: 48.
Status: Ongoing, recruitment ended. Start date (EU): 2023-10-02. Decision date: 2023-02-23. Results received: No. Last updated: 2025-04-25.
Decision dates by country: FR: 2023-02-23, BE: 2023-02-28

Condition(s): Triple negative metastatic breast cancer
Product: Trodelvy 200 mg powder for concentrate for solution for infusion.

Primary endpoint: The primary endpoint is anti-tumor activity of sacituzumab govitecan (SG) measured by the objective response rate (ORR) based on investigator assessment. ORR is defined as the number of patients with at least a confirmed complete response (CR) or partial response (PR), based on the best objective response values while not having started a new anticancer therapy. Treatment objective response will be radiologically assessed every 6 weeks using RECIST v1.1.
Endpoint(s): Efficacy: • PFS is defined as the time from date of first dose until the date of the first objective documentation of disease progression (PD) or death from any cause, whichever occurs first. For patients without documented radiological progression, follow-up will be censored at the date of last radiological assessment without progression, unless death occurs within 12 weeks following the date last known progression-free, in which case the death will be counted as a PFS event., Efficacy: • DOR is defined as the time from the date of the first documentation of objective response (CR or PR) to the date of the first documentation of PD or death due to any cause., Efficacy: • CBR is defined as the presence of at least a PR or CR, or a stable disease (SD) while not having started a new anticancer therapy., Efficacy: • OS is defined as the time from date of first dose until death. Patients alive at last follow-up will be censored at this date., Safety: Safety and tolerability of sacituzumab govitecan will be evaluated through: frequency and severity of any adverse events (AEs), serious adverse events (SAEs) graded by NCI-CTCAE v5.0; proportion of treatment discontinuation, interruptions and dose reductions due to any AEs;, Exploratory endpoints: • Evaluation of TROP-2 dynamics and correlation with payload delivery and efficacy using biopsies at baseline, on-treatment and at progression, Exploratory endpoints: • Genomic alterations of interest through whole exome sequencing (WES) and HTG-Edge Seq on tumor and ctDNA samples collected pretreatment and upon progression, Exploratory endpoints: • Determination of CTCs levels at baseline and tumor CTCs phenotype to assess tumor heterogeneity and to evaluate the predictive value of CTCs on the objective response and survival, Exploratory endpoints: • Determination of SG impact on tissue-resident memory T (TRM) cells, myeloid cells, and other immune cells; immunogenic cell death (ICD) associated to SG treatment

Source: https://euclinicaltrials.eu/ctis-public/view/2022-502369-10-00